EU clinical trial 2024-518358-17-00: SAFE-ESO_Phase II study evaluating safety and efficacy of Tislelizumab for elderly patients unfit for chemotherapy, with advanced esophageal squamous-cell carcinoma
Protocol code: PHRC K 2023 JARY
Sponsor: University Hospital Of Clermont-Ferrand (Hospital/Clinic/Other health care facility). Phase: Therapeutic exploratory (Phase II). Countries: France (ongoing, recruiting).
Therapeutic area(s): Diseases [C] - Neoplasms [C04]
Gender: Female, Male. Age: 18-64 years, 65+ years. Enrolment: 95.
Status: Ongoing, recruiting. Start date (EU): 2025-10-06. Decision date: 2025-04-17. Results received: No. Last updated: 2026-04-13.

Condition(s): Squamous cell carcinoma of the esophagus
Product: Tevimbra 100 mg concentrate for solution for infusion

Primary endpoint: Percentage of patients alive at 6 months in elderly patients, not eligible to platinum-based chemotherapy, treated by anti-PD1 Tislelizumab alone as first-line treatment for an advanced esophageal squamous-cell carcinoma (ESCC).
Endpoint(s): • Safety according to NCI-CTCAE version 5.0, • Overall survival (OS) at 6 months depending on PD-L1 expression, • Overall response rate (ORR) according to RECIST 1.1 criteria, • Progression-free survival (PFS) at 3 and 6 months according to RECIST 1.1 criteria and depending on PDL1 expression, • Patients’ health-related quality of life (EORTC QLQC30, OES-18 and QLQ-ELD14 scales), • OS and PFS according to geriatric parameters (complete G-CODE, and ADL and IADL sub-scales), • Prognostic value of immune biomarkers

Source: https://euclinicaltrials.eu/ctis-public/view/2024-518358-17-00